EU clinical trial 2023-508773-82-00: ETOP 25-23 ADOPT-lung: An international, multicentre, open-label randomised phase III trial to evaluate the benefit of adding adjuvant durvalumab after neoadjuvant chemotherapy plus durvalumab in patients with stage IIB-IIIB (N2) resectable NSCLC
Protocol code: ETOP25-23 ADOPT-lung
Sponsor: ETOP IBCSG Partners Foundation (Laboratory/Research/Testing facility). Phase: Therapeutic confirmatory (Phase III). Countries: Italy (ongoing, recruiting), Austria (ongoing, recruiting), Belgium (ongoing, recruiting), Estonia (ongoing, recruiting), France (ongoing, recruiting), Ireland (ongoing, recruiting), Netherlands (authorised, recruitment pending).
Therapeutic area(s): Diseases [C] - Neoplasms [C04]; Diseases [C] - Respiratory Tract Diseases [C08]
Gender: Female, Male. Age: 18-64 years, 65+ years. Enrolment: 335.
Start date (EU): 2025-05-06. Decision date: 2024-09-10. Results received: No. Last updated: 2026-07-31.
Decision dates by country: EE: 2024-09-16, AT: 2024-09-15, IE: 2025-05-02, NL: 2025-05-06, BE: 2024-09-19, IT: 2024-09-12, FR: 2024-09-16

Condition(s): Stage IIB-IIIB (N2) resectable non small cell lung cancer
Product: CISPLATIN, PACLITAXEL, GEMCITABINE, CARBOPLATIN, IMFINZI 50 mg/mL concentrate for solution for infusion., PEMETREXED

Primary endpoint: DFS in patients without pCR, measured from randomisation.
Endpoint(s): Assessed in the adjuvant treatment phase (after randomisation) • DFS in patients with pCR. • Overall survival (OS) in patients with/without pCR, ITT. • DFS in patients with/without ctDNA clearance. • Time to recurrence (TTR) in patients with/without pCR, ITT. • Time to treatment discontinuation (TTD) in patients with/without pCR, ITT. • Toxicity according to CTCAE v5.0., Key secondary endpoint: (hierarchically tested) DFS in the ITT cohort (with and without pCR), measured from randomisation.

Source: https://euclinicaltrials.eu/ctis-public/view/2023-508773-82-00